EU clinical trial 2024-514714-12-00: A Randomized, Double-Blind, Placebo-Controlled Study of Nab-Paclitaxel and Gemcitabine With Or Without SBP-101 in Subjects Previously Untreated for Metastatic Pancreatic Ductal Adenocarcinoma
Protocol code: CL-SBP-101-04
Sponsor: Panbela Therapeutics Inc. (Pharmaceutical company). Phase: Phase II and Phase III (Integrated). Countries: Italy (ended), Belgium (ended), Germany (ended), Austria (ended), Spain (ended), France (ended).
Therapeutic area(s): Diseases [C] - Neoplasms [C04]
Gender: Female, Male. Age: 18-64 years, 65+ years. Enrolment: 407.
Status: Ended. Start date (EU): 2022-11-11. End date (EU): 2025-03-28. Decision date: 2024-11-20. Results received: No. Last updated: 2024-11-28.
Decision dates by country: AT: 2024-11-25, BE: 2024-11-25, FR: 2024-11-22, DE: 2024-11-20, IT: 2024-11-26, ES: 2024-11-28

Condition(s): Metastatic Pancreatic Ductal Adenocarcinoma
Product: SBP-101, SODIUM CHLORIDE, Abraxane 5 mg/ml powder for dispersion for infusion., Gemcitabin Hikma 38 mg/ml Konzentrat zur Herstellung einer Infusionslösung

Primary endpoint: OS defined as the time (days) from Study Day 1 (the date of first dose of study drug treatment) until death from any cause.
Endpoint(s): PFS defined as time until disease progression or death from any cause, whichever occurs first. ORR defined as percentage of subjects with a best overall response of CR or PR, determined using RECIST 1.1 criteria. DCR defined as percentage of subjects with confirmed CR, PR, or SD for at least 16 weeks. DoR in subjects who achieve a CR or PR, defined as time from onset of first CR or PR until disease progression or death from any cause. QoL, assessed using EORTC QLQ-30 and QLQ-PAN26 questionnaires

Source: https://euclinicaltrials.eu/ctis-public/view/2024-514714-12-00